EU clinical trial 2025-524045-27-00: Late immunity following single immunization with GA2 sporozoites (GACHA)
Sponsor: Leids Universitair Medisch Centrum (LUMC) (Hospital/Clinic/Other health care facility). Phase: Phase I and Phase II (Integrated)- Other. Countries: Netherlands (ongoing, recruitment ended).
Therapeutic area(s): Diseases [C] - Parasitic Diseases [C03]
Gender: Female, Male. Age: 18-64 years. Enrolment: 20.
Status: Ongoing, recruitment ended. Start date (EU): 2026-03-11. Decision date: 2026-03-09. Results received: No. Last updated: 2026-03-09.

Condition(s): Falciparum malaria

Source: https://euclinicaltrials.eu/ctis-public/view/2025-524045-27-00